EU clinical trial 2023-507568-38-00: A Study with ABBV-CLS-484 Alone and in Combination in Subjects with Advanced Tumor Cancer
Protocol code: M20-431
Sponsor: Calico Life Sciences LLC (Pharmaceutical company). Phase: Human Pharmacology (Phase I)- First administration to humans. Countries: France (ongoing, recruiting), Spain (ongoing, recruiting).
Therapeutic area(s): Diseases [C] - Neoplasms [C04]
Gender: Female, Male. Age: 18-64 years, 65+ years. Enrolment: 200.
Status: Ongoing, recruiting. Start date (EU): 2022-01-14. Decision date: 2024-03-11. Results received: No. Last updated: 2025-11-14.
Decision dates by country: FR: 2024-03-11, ES: 2024-03-12

Condition(s): Metastatic or locally advanced tumors

Source: https://euclinicaltrials.eu/ctis-public/view/2023-507568-38-00